EU clinical trial 2022-501457-37-00: Phase III Clinical Trial for CPX-351 in Myeloid Leukemia in Children with Down Syndrome 2018
Protocol code: ML-DS2018
Sponsor: GPOH gGmbH (Patient organisation/association). Phase: Therapeutic confirmatory (Phase III). Countries: Germany (ongoing, recruiting), Austria (ongoing, recruitment ended), Netherlands (ongoing, recruiting), Poland (ongoing, recruiting), Belgium (ongoing, recruiting), Italy (authorised, recruiting), Czechia (authorised, recruitment pending).
Therapeutic area(s): Diseases [C] - Hemic and Lymphatic Diseases [C15]
Gender: Female, Male. Age: 0-17 years. Enrolment: 220.
Start date (EU): 2024-10-28. Decision date: 2023-08-08. Results received: No. Last updated: 2026-07-08.
Decision dates by country: AT: 2023-08-14, NL: 2023-08-08, BE: 2023-11-30, IT: 2025-02-12, DE: 2023-08-09, CZ: 2025-05-29, PL: 2023-12-21

Condition(s): Myeloid Leukemia in Children with Down Syndrome
Product: Vyxeos Liposomal 44 mg/100 mg powder for concentrate for solution for infusion.

Primary endpoint: Event-free survival (EFS), defined as time from diagnosis to the first event or last follow-up. Events are death from any cause, failure to achieve remission, relapse, and secondary malignancy. Failure to achieve remission is considered as an event on day 0.
Endpoint(s): Overall survival (OS), as defined as the time of diagnosis to death from any cause or last follow-up, Disease-free survival (DFS), Early Response Rate (CR, CRp, CRi) after induction, Treatment-related mortality (TRM), Minimal residual disease (FACS and NGS), Adverse events (according to NCI CTCAE v4.0), Duration of myelosuppression (neutrophils <0.5 Gpt/L)

Source: https://euclinicaltrials.eu/ctis-public/view/2022-501457-37-00